EU clinical trial 2022-501019-15-00: Phase I/II study assessing radioligand therapy (RLT) using 177Lu-PentixaTher for relapsed/refractory CXCR4+ acute leukemia.
Protocol code: RC20_0123
Sponsor: Centre Hospitalier Universitaire De Nantes (Hospital/Clinic/Other health care facility). Phase: Phase I and Phase II (Integrated)- Other. Countries: France (ongoing, recruiting).
Therapeutic area(s): Analytical, Diagnostic and Therapeutic Techniques and Equipment [E] - Anesthesia and Analgesia [E03]
Gender: Female, Male. Age: 18-64 years, 65+ years. Enrolment: 21.
Status: Ongoing, recruiting. Start date (EU): 2024-10-22. Decision date: 2024-03-25. Results received: No. Last updated: 2026-06-26.

Condition(s): Acute Leukemia

Source: https://euclinicaltrials.eu/ctis-public/view/2022-501019-15-00